EU clinical trial 2024-512847-21-00: A Phase 2 Single Arm Open-Label Clinical Trial of ADP-A2M4 SPEAR™ T cells in subjects with Advanced Synovial Sarcoma or Myxoid/Round Cell Liposarcoma (SPEARHEAD 1 STUDY)
Protocol code: ADP-0044-002
Sponsor: USWM Ct LLC (Pharmaceutical company). Phase: Therapeutic exploratory (Phase II). Countries: France (ongoing, recruitment ended), Spain (ongoing, recruitment ended).
Therapeutic area(s): Diseases [C] - Neoplasms [C04]
Gender: Female, Male. Age: 0-17 years, 18-64 years, 65+ years. Enrolment: 48.
Status: Ongoing, recruitment ended. Start date (EU): 2019-12-11. Decision date: 2024-06-10. Results received: No. Last updated: 2026-05-27.
Decision dates by country: ES: 2024-06-10, FR: 2024-06-10

Condition(s): Advanced Synovial Sarcoma, Myxoid/Round Cell Liposarcoma
Product: Afamitresgene autoleucel

Primary endpoint: Overall Response Rate (ORR) per RECIST v1.1 by independent review in Cohort 1.
Endpoint(s): For Cohort 1 and across Cohorts (overall) separately for both all subjects and synovial sarcoma (SS) only, and in addition Cohort 2 and 3 combined (for SS only):: • Adverse events (AEs) including serious adverse events (SAEs) • Incidence, severity and duration of the AEs of special interest • Replication Competent Lentivirus (RCL) • T cell Clonality and Insertional oncogenesis (IO), Across Cohorts separately for both all subjects and synovial sarcoma (SS) only,and in addition Cohort 2 and 3 combined (for SS only): •Overall Response Rate (ORR) per RECIST v1.1 by independent review. For Cohort 1 and across Cohorts (overall) separately for both all subjects and synovial sarcoma (SS) only,and in addition Cohort 2 and 3 combined (for SS only). Please refer protocol for full information, For Cohort 1 and across cohorts (overall) separately for all subjects and SS only, and in addition Cohorts 2 and 3 combined (SS only): • Retention of additional tumor tissue during Pre-screening to enable development and validation of the MAGE-A4 antigen expression companion diagnostic assay, For Cohort 1 and across Cohorts (overall) separately for all subjects and SS only, and in addition Cohorts 2 and 3 combined (SS only): •Peak persistence and other relevant PK parameters of ADP-A2M4 cells

Source: https://euclinicaltrials.eu/ctis-public/view/2024-512847-21-00